EU clinical trial 2024-516993-31-00: A Phase 3, Randomized, Double-blind, Study of Belzutifan + Zanzalintinib Versus Belzutifan + Placebo in Participants with Advanced RCC who have progressed on or after both PD-1/L1 and VEGF-TKI therapies in sequence or in combination (LITESPARK-034)
Protocol code: MK-6482-034
Sponsor: Merck Sharp & Dohme LLC (Pharmaceutical company). Phase: Therapeutic confirmatory (Phase III). Countries: Denmark (ongoing, recruiting), Spain (ongoing, recruiting), Netherlands (ongoing, recruiting), Germany (ongoing, recruiting), France (ongoing, recruiting), Czechia (ongoing, recruiting), Poland (ongoing, recruiting), Italy (ongoing, recruiting), Greece (ongoing, recruiting).
Therapeutic area(s): Diseases [C] - Neoplasms [C04]
Gender: Female, Male. Age: 18-64 years, 65+ years. Enrolment: 311.
Status: Ongoing, recruiting. Start date (EU): 2026-05-11. Decision date: 2026-05-04. Results received: No. Last updated: 2026-05-20.
Decision dates by country: CZ: 2026-05-05, DK: 2026-05-04, DE: 2026-05-06, GR: 2026-05-04, ES: 2026-05-07, NL: 2026-05-11, PL: 2026-05-08, IT: 2026-05-05, FR: 2026-05-20

Condition(s): Renal Cell Carcinoma
Product: XL092, BELZUTIFAN, XL092, XL092, Placebo to Zanzalintinib

Primary endpoint: Progression Free Survival (PFS), Overall Survival (OS)
Endpoint(s): Objective Response Rate (ORR), Duration of Response (DOR), Number of Participants Who Experience One or More Adverse Events (AEs), Number of Participants Who Discontinue Study Treatment Due to an AE, Change from Baseline in European Organisation for Research and Treatment of Cancer Quality of Life Questionnaire-Core 30 (EORTC QLQ-C30) Global Health Status (Item 29) and Quality of Life (Item 30) Combined Score, Change from Baseline in the EORTC QLQ-C30 Physical Functioning (Items 1-5) Combined Score, Change from Baseline in the EORTC QLQ-C30 Role Functioning (Items 6 and 7) Combined Score, Change From Baseline in Disease Symptoms Using the Functional Assessment of Cancer Therapy-Kidney Symptom Index-Disease-related Symptoms (FKSI-DRS) (Items 1-9) Score, Time to Deterioration (TTD) in EORTC QLQ-C30 Global Health Status (Item 29) and Quality of Life (Item 30) Combined Score, TTD in EORTC QLQ-C30 Physical Functioning (Items 1-5) Score, TTD in EORTC QLQ-C30 Role Functioning (Items 6 and 7) Score, TTD in Disease Symptoms Using the FKSI-DRS (Items 1-9) Score

Source: https://euclinicaltrials.eu/ctis-public/view/2024-516993-31-00